EU clinical trial 2025-522301-37-00: A multicenter, randomized, double-blind, placebo-controlled, dose-ranging Phase IIb study to assess the efficacy and safety of GIA632 in adult participants with non-segmental vitiligo followed by an extension period
Protocol code: CGIA632B12201
Sponsor: Novartis Pharma AG (Pharmaceutical company). Phase: Therapeutic exploratory (Phase II). Countries: Germany (temporarily halted), Spain (temporarily halted), Netherlands (authorised, recruitment pending), France (temporarily halted), Italy (temporarily halted).
Therapeutic area(s): Diseases [C] - Skin and Connective Tissue Diseases [C17]; Diseases [C] - Immune System Diseases [C20]
Gender: Female, Male. Age: 18-64 years, 65+ years. Enrolment: 80.
Start date (EU): 2026-06-24. Decision date: 2026-06-08. Results received: No. Last updated: 2026-06-11.
Decision dates by country: FR: 2026-06-09, DE: 2026-06-10, IT: 2026-06-08, ES: 2026-06-11, NL: 2026-06-09

Condition(s): Nonsegmental vitiligo
Product: GIA632, Placebo to GIA632

Primary endpoint: Percentage change from baseline to Week 24 in F-VASI score.
Endpoint(s): Achievement of ≥75% improvement from baseline in the F-VASI (F-VASI75) at Week 24., Percentage change from baseline to Week 24 in T-VASI score., Achievement of ≥50% improvement from baseline in T-VASI (T-VASI50) at Week 24., Achievement of F-VASI50, F-VASI75, and F- VASI90 at Week 12, Week 24, Week 36, and Week 48., Achievement of T-VASI50, T-VASI75, and T- VASI90 at Weeks 12, Week 24, Week 36, and Week 48., Achievement of VNS of 4 or 5, at Week 12, Week 24, Week 36, and at Week 48., Occurrence of treatment-emergent adverse events (TEAEs) and serious adverse events (SAEs).

Source: https://euclinicaltrials.eu/ctis-public/view/2025-522301-37-00